EU clinical trial 2024-518260-13-00: Single dose pharmacokinetics of selected antibiotics in plasma and soft tissues of healthy volunteers.
Sponsor: Medical University Of Vienna (Educational Institution). Phase: Human Pharmacology (Phase I)- Other. Countries: Austria (ongoing, recruiting).
Therapeutic area(s): Diseases [C] - Bacterial Infections and Mycoses [C01]
Gender: Female, Male. Age: 18-64 years. Enrolment: 90.
Status: Ongoing, recruiting. Start date (EU): 2023-05-15. Decision date: 2024-10-29. Results received: No. Last updated: 2025-11-06.

Condition(s): Healthy volunteers

Source: https://euclinicaltrials.eu/ctis-public/view/2024-518260-13-00